EU clinical trial 2024-517699-39-00: Prolonged corticosteroid therapy in scheduled cardiac surgery in intermediate/high-risk patients: a prospective multicenter randomized controlled double-blind placebo-controlled study
Protocol code: PI2024_843_0047
Sponsor: Centre Hospitalier Universitaire Amiens Picardie (Hospital/Clinic/Other health care facility). Phase: Therapeutic confirmatory (Phase III). Countries: France (authorised, recruitment pending).
Therapeutic area(s): Diseases [C] - Cardiovascular Diseases [C14]
Gender: Female, Male. Age: 18-64 years. Enrolment: 196.
Status: Authorised, recruitment pending. Decision date: 2025-04-30. Results received: No. Last updated: 2025-04-30.

Condition(s): high /medium risk cardiac surgery, acute renal failure
Product: HYDROCORTISONE, FLUDROCORTISONE, SODIUM CHLORIDE, CELLULOSE, MICROCRYSTALLINE

Primary endpoint: The primary endpoint is a composite of the occurrence within 7 days of surgery of one of the following 3 events: - Acute renal failure (ARF). - Occurrence of a postoperative pulmonary complication (PPC). - Use of noradrenaline.
Endpoint(s): Major cardiac events (MCE), Stroke will be defined by the sudden onset of neurological deficit and confirmed by brain imaging., The total quantity of noradrenaline will be expressed in mg and will correspond to the dose received from admission to intensive care until day 7 after surgery., The side-effects of interest are as follows: Hypernatremia defined by a natraemia > 145 mmol/l. Hyperglycemia defined by the need for insulin therapy. One of the following infections: urinary tract infection, postoperative pneumonitis, mediastinitis., Mortality at 28 days is defined as death from any cause from the date of surgery up to and including day 28.

Source: https://euclinicaltrials.eu/ctis-public/view/2024-517699-39-00